EU clinical trial 2024-520206-19-00: A Phase 3, Randomized, Double-Blind, Multicenter Study to Evaluate the Efficacy and Safety of Dotinurad Compared With Allopurinol in Adult Participants With Hyperuricemia Associated With Gout
Protocol code: FYU-981-CRYS-301
Sponsor: Crystalys Therapeutics Inc. (Pharmaceutical company). Phase: Therapeutic confirmatory (Phase III). Countries: Spain (ongoing, recruiting), Poland (ongoing, recruiting).
Therapeutic area(s): Diseases [C] - Musculoskeletal Diseases [C05]
Gender: Female, Male. Age: 18-64 years, 65+ years. Enrolment: 65.
Status: Ongoing, recruiting. Start date (EU): 2025-12-02. Decision date: 2025-10-23. Results received: No. Last updated: 2026-03-24.
Decision dates by country: ES: 2025-10-23, PL: 2025-10-31

Condition(s): Hyperuricemia associated with gout.
Product: Placebo capsules to match overencapsulated dotinurad tablets and overencapsulated allopurinol tablets contain microcrystalline cellulose in a gelatin capsule., ALLOPURINOL, ALLOPURINOL, ALLOPURINOL, Dotinurad

Primary endpoint: 1. Proportion of participants with an sUA level <6.0 mg/dL at Week 24.
Endpoint(s): 1. Proportion of participants with an sUA level <6.0 mg/dL at Weeks 16, 20, and 24, inclusive., 2. Mean rate of gout flares requiring treatment from Week 36 through Week 64., 3. Proportion of participants with an sUA level <5.0 mg/dL at Week 24 AND no gout flares requiring treatment from Week 36 through Week 64.

Source: https://euclinicaltrials.eu/ctis-public/view/2024-520206-19-00